EU clinical trial 2023-509120-17-00: A Randomized Open-Label, Phase 3 Study to Evaluate Imetelstat (GRN163L) Versus Best Available Therapy (BAT) in Patients with Intermediate-2 or High-risk Myelofibrosis (MF) Relapsed / Refractory (R/R) to Janus Kinase (JAK)-Inhibitor
Protocol code: GRN163LMYF3001
Sponsor: Geron Corp. (Pharmaceutical company). Phase: Therapeutic confirmatory (Phase III). Countries: Denmark (ongoing, recruitment ended), Austria (ongoing, recruitment ended), Portugal (ongoing, recruitment ended), Poland (ongoing, recruitment ended), Germany (ongoing, recruitment ended), Spain (ongoing, recruitment ended), Bulgaria (ended), Italy (ongoing, recruitment ended), Belgium (ongoing, recruitment ended), France (ongoing, recruitment ended), Hungary (ongoing, recruitment ended).
Therapeutic area(s): Diseases [C] - Neoplasms [C04]
Gender: Female, Male. Age: 18-64 years, 65+ years. Enrolment: 260.
Start date (EU): 2021-04-12. Decision date: 2024-03-19. Results received: No. Last updated: 2026-06-14.
Decision dates by country: DK: 2024-03-19, ES: 2024-03-20, AT: 2024-03-25, BE: 2024-03-27, FR: 2024-03-19, HU: 2024-03-19, DE: 2024-03-20, PT: 2024-03-19, PL: 2024-03-25, BG: 2024-03-26, IT: 2024-03-21

Condition(s): Myelofibrosis
Product: IMETELSTAT

Primary endpoint: Overall survival (OS), defined as the time interval from randomization date to date of death from any cause.
Endpoint(s): Symptom response rate at Week 24 (defined as the proportion of patients who have ≥ 50% reduction in TSS at Week 24 from baseline as measured by the MFSAF v4.0), Progression-Free Survival, defined as the time interval from randomization date to the first date of disease progression (worsening splenomegaly or leukemic transformation per 2013 IWG-MRT criteria) or death from any cause, whichever occurs first., Spleen response rate at Week 24 (defined as the proportion of patients who achieve ≥ 35% reduction in spleen volume at Week 24 from baseline as measured by imaging scans). For additional secondary end points please refer to the study protocol.

Source: https://euclinicaltrials.eu/ctis-public/view/2023-509120-17-00